EU clinical trial 2023-507353-15-00: An open-label extension trial of the long-term safety and efficacy of BI 1015550 taken orally in patients with idiopathic pulmonary fibrosis (IPF) and progressive pulmonary fibrosis (PPF) (FIBRONEER™-ON)
Protocol code: 1305-0031
Sponsor: Boehringer Ingelheim International GmbH, Boehringer Ingelheim RCV GmbH & Co. KG, Boehringer Ingelheim Espana S.A. (Pharmaceutical company). Phase: Therapeutic confirmatory (Phase III). Countries: Spain (ongoing, recruiting), Denmark (ongoing, recruiting), Slovenia (ended), Croatia (ongoing, recruiting), Norway (ongoing, recruiting), Italy (ongoing, recruiting), Belgium (ongoing, recruiting), Czechia (ongoing, recruiting), Finland (ongoing, recruiting), Portugal (ongoing, recruiting), Ireland (ongoing, recruiting), Hungary (ongoing, recruiting), Greece (ongoing, recruiting), Sweden (ongoing, recruiting), Austria (ongoing, recruiting), Estonia (ongoing, recruiting), France (ongoing, recruiting), Germany (ongoing, recruitment ended), Poland (ongoing, recruiting), Netherlands (ongoing, recruiting).
Therapeutic area(s): Diseases [C] - Respiratory Tract Diseases [C08]
Gender: Female, Male. Age: 18-64 years, 65+ years. Enrolment: 551.
Start date (EU): 2024-09-10. Decision date: 2024-04-19. Results received: No. Last updated: 2026-03-09.
Decision dates by country: SI: 2024-04-22, AT: 2024-04-24, BE: 2024-04-23, HR: 2024-04-22, CZ: 2024-04-23, DK: 2024-04-19, EE: 2024-04-23, FI: 2024-04-23, FR: 2024-04-24, GR: 2024-04-23, IE: 2024-04-24, PT: 2024-04-23, ES: 2024-04-19, SE: 2024-04-24, NL: 2024-04-19, NO: 2024-04-22, PL: 2024-04-24, DE: 2024-04-22, HU: 2024-04-29, IT: 2024-04-23

Condition(s): idiopathic pulmonary fibrosis (IPF), progressive pulmonary fibrosis (PPF)
Product: BI 1015550, BI 1015550

Primary endpoint: any adverse event over the course of the extension trial (yes/no) i.e. up until the follow-up/end of study visit planned at the latest at week 99.
Endpoint(s): Absolute change from baseline in FVC (mL) and in % predicted FVC over time, Time to absolute decline in FVC % predicted of >10% from baseline over the duration of the trial, Time to first acute IPF/PPF exacerbation, first hospitalisation for respiratory cause, or death (whichever occurs first) over the duration of the trial, Time to first acute IPF/PPF exacerbation or death over the duration of the trial, Time to hospitalisation for respiratory cause or death over the duration of the trial, Time to absolute decline in FVC % predicted of >10% from baseline or death over the duration of the trial, Time to relative decline in FVC % predicted of >10% from baseline or death over the duration of the trial

Source: https://euclinicaltrials.eu/ctis-public/view/2023-507353-15-00